EU clinical trial 2024-517249-15-00: ISIS 721744-CS3: An Open-Label Extension Study of ISIS 721744 in Patients with Hereditary Angioedema
Protocol code: ISIS721744-CS3
Sponsor: Ionis Pharmaceuticals Inc. (Pharmaceutical company). Phase: Therapeutic exploratory (Phase II). Countries: Netherlands (ended).
Therapeutic area(s): Phenomena and Processes [G] - Genetic Phenomena [G05]
Gender: Female, Male. Age: 18-64 years. Enrolment: 7.
Status: Ended. Start date (EU): 2020-10-22. End date (EU): 2024-12-19. End date: 2025-01-24. Decision date: 2024-11-04. Results received: Yes. Last updated: 2024-11-04.

Condition(s): Hereditary Angioedema
Product: ISIS 721744

Primary endpoint: 1. Percentage of Participants with at Least One Treatment-emergent Adverse Event (TEAE), Graded by Severity
Endpoint(s): 1. The time-normalized HAE attacks (monthly) by treatment, 2. Plasma PKK levels, plasma proenzyme activation and cHK levels, 3. Consumption of on-demand medications, 4. Angioedema Quality of Life (AE-QoL) questionnaire score

Source: https://euclinicaltrials.eu/ctis-public/view/2024-517249-15-00